EU clinical trial 2023-510277-33-00: Efficacy and Safety of Oral Midazolam for Providing Care to Patients Who Refuse Treatment and Have Moderately Severe to Severe Neurocognitive Disorders
Protocol code: 38RC21.0436
Sponsor: Centre Hospitalier Universitaire Grenoble Alpes (Hospital/Clinic/Other health care facility). Phase: Therapeutic exploratory (Phase II). Countries: France (ongoing, recruitment ended).
Therapeutic area(s): Not possible to specify
Gender: Female, Male. Age: 18-64 years, 65+ years. Enrolment: 30.
Status: Ongoing, recruitment ended. Start date (EU): 2026-04-21. Decision date: 2024-05-13. Results received: No. Last updated: 2026-04-17.

Condition(s): Neurocognitive Disorders and Agitation in Older Adults
Product: MIDAZOLAM

Primary endpoint: A decrease of at least two points on the “resistance to treatment” subscale of the Pittsburgh Scale
Endpoint(s): Care Acceptance Scale according to Rignell et al. (2007), measured at the end of care, Overall score on the Pittsburgh Agitation Scale, measured 30 to 45 minutes after administration of oral midazolam gel. This scale assesses four dimensions, rated on a scale of 0 to 4. Subscore for resistance to care, Measurement of oxygen saturation, respiratory rate, and heart rate, and recording of serious and non-serious adverse events occurring following administration of midazolam gel, Satisfaction survey on healthcare providers’ perception of patient well-being (unvalidated questionnaire developed specifically for the clinical trial), completed at the end of care

Source: https://euclinicaltrials.eu/ctis-public/view/2023-510277-33-00